EU clinical trial 2025-524255-32-00: Mechanisms of Resistance to anti-PD-1 Therapy in cutaneous Squamous Cell Carcinomas: Impact of Tumor Cell Plasticity on Promoting Myeloid Suppressor Cell Infiltration. A phase II single arm, unicenter study of cemiplimab in patients with locally advanced cSCCs.
Protocol code: CEMIRESIST
Sponsor: Fundacio Institut D'Investigacio Biomedica De Bellvitge IDIBELL (Laboratory/Research/Testing facility). Phase: Therapeutic exploratory (Phase II). Countries: Spain (authorised, recruitment pending).
Therapeutic area(s): Diseases [C] - Neoplasms [C04]
Gender: Female, Male. Age: 18-64 years, 65+ years. Enrolment: 15.
Status: Authorised, recruitment pending. Decision date: 2026-04-24. Results received: No. Last updated: 2026-04-24.

Condition(s): Cutaneous squamous cell carcinoma (ccSCC)
Product: LIBTAYO 350 mg concentrate for solution for infusion.

Primary endpoint: Primary translational end points are immunologic, genomic, and pathological correlations of response to cemiplimab in blood and tumor samples.
Endpoint(s): Flow cytometry assays, Multiplex immunohistochemistry, Single-cell RNA (scRNA) Seq assays, Progression-free survival (PFS), Overall Response Rate (ORR) per RECIST 1.1

Source: https://euclinicaltrials.eu/ctis-public/view/2025-524255-32-00